EU clinical trial 2024-514273-22-00: A Phase 1/2 Open-Label, Umbrella Platform Design Study of Investigational Agents in Combination With Pembrolizumab (MK-3475) With or Without Chemotherapy in Participants With 1L Untreated Locally Advanced Unresectable/Metastatic Esophageal Cancer: KEYMAKER-U06 Substudy 06E
Protocol code: MK-3475-06E
Sponsor: Merck Sharp & Dohme LLC (Pharmaceutical company). Phase: Phase I and Phase II (Integrated)- Other. Countries: Czechia (ongoing, recruiting), Germany (ongoing, recruiting), Italy (ongoing, recruiting), France (ongoing, recruiting), Norway (ongoing, recruiting).
Therapeutic area(s): Diseases [C] - Neoplasms [C04]
Gender: Female, Male. Age: 18-64 years, 65+ years. Enrolment: 38.
Status: Ongoing, recruiting. Start date (EU): 2025-09-02. Decision date: 2025-04-07. Results received: No. Last updated: 2026-07-19.
Decision dates by country: DE: 2025-04-10, NO: 2025-04-11, FR: 2025-04-07, CZ: 2025-04-08, IT: 2025-04-09

Condition(s): Esophageal squamous cell carcinoma
Product: PARACETAMOL, Ifinatamab Deruxtecan, CALCIUM LEVOFOLINATE, CALCIUM FOLINATE, FLUOROURACIL, MK-2870, OXALIPLATIN, MK-2870, KEYTRUDA 25 mg/mL concentrate for solution for infusion

Primary endpoint: Percentage of Participants who Experience Dose Limiting Toxicities (DLTs) During the Safety Lead-In Phase, Percentage of Participants who Experience an Adverse Event (AE), Objective Response Rate (ORR)
Endpoint(s): Duration of response (DOR), Progression-free survival (PFS), Overall survival (OS), Disease control rate (DCR), Maximum plasma concentration (Cmax) of ifinatamab deruxtecan (I-DXd), Time to maximum plasma concentration (Tmax) of I-DXd, Area Under the Concentration-Time Curve from Time 0 to Last Measurable Plasma Concentration (AUC-Last) of I-DXd., Area Under the Concentration-Time Curve from Time 0 to the End of the Dosing Period (AUC-tau) of I-DXd, The Percentage of participants with antidrug antibodies (ADA) against I-DXd., The Percentage of participants with treatment-emergent ADA against I-DXd.

Source: https://euclinicaltrials.eu/ctis-public/view/2024-514273-22-00